EU clinical trial 2026-525213-31-00: A Phase 2 Open-Label, Umbrella Platform Design Study of Investigational Agent(s) in Participants With 2L/3L Unresectable Locally Advanced or Metastatic Esophageal Cancer: KEYMAKER-U06 Substudy 06F
Protocol code: MK-3475-06F
Sponsor: Merck Sharp & Dohme LLC (Pharmaceutical company). Phase: Therapeutic exploratory (Phase II). Countries: Czechia (authorised, recruiting), Germany (authorised, recruitment pending), France (authorised, recruitment pending), Norway (authorised, recruiting).
Therapeutic area(s): Diseases [C] - Neoplasms [C04]
Gender: Female, Male. Age: 18-64 years, 65+ years. Enrolment: 12.
Start date (EU): 2026-05-21. Decision date: 2026-05-12. Results received: No. Last updated: 2026-05-12.
Decision dates by country: CZ: 2026-05-12, FR: 2026-05-12, DE: 2026-05-12, NO: 2026-05-12

Condition(s): Esophageal squamous cell carcinoma
Product: Ifinatamab Deruxtecan

Primary endpoint: Objective response rate (ORR)
Endpoint(s): Duration of response (DOR), Progression-free survival (PFS), Overall survival (OS), Number of participants who experience an adverse event (AE), Number of participants who discontinue study intervention due to an AE

Source: https://euclinicaltrials.eu/ctis-public/view/2026-525213-31-00